EU clinical trial 2024-511764-86-00: Felzartamab in late ABMR
Sponsor: Medical University Of Vienna (Educational Institution). Phase: Therapeutic exploratory (Phase II). Countries: Germany (ongoing, recruiting), Austria (ongoing, recruiting).
Therapeutic area(s): Diseases [C] - Pathological Conditions, Signs and Symptoms [C23]
Gender: Female, Male. Age: 18-64 years, 65+ years. Enrolment: 30.
Status: Ongoing, recruiting. Start date (EU): 2021-09-07. Decision date: 2024-12-11. Results received: No. Last updated: 2025-04-28.
Decision dates by country: DE: 2024-12-11, AT: 2024-12-11

Condition(s): late antibody mediated renal transplant rejection

Source: https://euclinicaltrials.eu/ctis-public/view/2024-511764-86-00